EU clinical trial 2023-503866-22-00: A PHASE 1, RANDOMIZED, PLACEBO-CONTROLLED, SINGLE ASCENDING DOSE AND MULTIPLE ASCENDING DOSE ESCALATION STUDY OF THE SAFETY, TOLERABILITY, PHARMACOKINETICS AND PHARMACODYNAMICS OF MES-1022 IN HEALTHY HUMAN SUBJECTS
Protocol code: MESENTECH 01-2023
Sponsor: Mesentech Inc. (Pharmaceutical company). Phase: Human Pharmacology (Phase I)- First administration to humans. Countries: Netherlands (ended).
Therapeutic area(s): Diseases [C] - Musculoskeletal Diseases [C05]
Gender: Female, Male. Age: 18-64 years, 65+ years. Enrolment: 72.
Status: Ended. Start date (EU): 2023-08-11. End date (EU): 2024-11-18. Decision date: 2023-07-05. Results received: No. Last updated: 2024-10-24.

Condition(s): metabolic bone diseases

Source: https://euclinicaltrials.eu/ctis-public/view/2023-503866-22-00